EU clinical trial 2024-514468-26-00: An Open-Label, Multicenter, Phase 1b/2 Study of the Safety and Efficacy of KRT-232 Combined with Ruxolitinib in Patients with Primary Myelofibrosis (PMF), Post Polycythemia Vera MF (Post PV MF), Or Post Essential Thrombocythemia MF (Post ET MF) Who Have a Suboptimal Response to Ruxolitinib
Protocol code: KRT-232-109
Sponsor: Kartos Therapeutics Inc. (Pharmaceutical company). Phase: Phase I and Phase II (Integrated)- Other. Countries: France (ongoing, recruitment ended), Italy (ongoing, recruitment ended).
Therapeutic area(s): Diseases [C] - Neoplasms [C04]
Gender: Female, Male. Age: 18-64 years, 65+ years. Enrolment: 26.
Status: Ongoing, recruitment ended. Start date (EU): 2020-12-04. Decision date: 2024-10-30. Results received: No. Last updated: 2026-07-07.
Decision dates by country: FR: 2024-11-14, IT: 2024-10-30

Condition(s): Primary Myelofibrosis (PMF), Post–Polycythemia Vera MF (Post–PV-MF), Or Post–Essential Thrombocythemia MF (Post-ET-MF)
Product: RUXOLITINIB, Navtemadlin 25-15, RUXOLITINIB, RUXOLITINIB, RUXOLITINIB, Navtemadlin 25-60, Navtemadlin 10-60, Navtemadlin 10-15

Primary endpoint: - DLTs will be used to establish the MTD of navtemadlin in combination with ruxolitinib. The SRC will determine the RP2D based on safety and efficacy data of the combination of navtemadlin and ruxolitinib. - The proportion of subjects achieving SVR of ≥ 35% at Week 24 by MRI/CT scan (central review)
Endpoint(s): The proportion of subjects achieving ≥ 35% SVR at any time point from Baseline while on study, as assessed by MRI (or by CT scan for applicable subjects)., The percentage change in TSS as measured by the MFSAF v4.0 at any time point from Baseline while on study., Duration of a ≥ 35% reduction in SVR from Baseline as measured by MRI (or by CT scan for applicable subjects)., Reduction in spleen size from Baseline to each visit at which spleen is palpated, including the proportion of subjects who have a ≥ 50% decrease in spleen size, Red blood cell (RBC) transfusion usage: • Rate of RBC transfusion usage (average number of RBC units per patient-month) • Rate of change from RBC transfusion dependent to transfusion independent, The proportion of subjects with CR and PR at any time point, from Baseline while on study, defined according to International Working Group-Myeloproliferative Neoplasms Research and Treatment(IWG-MRT) and modified European Leukemia Net (ELN) criteria, OS is defined as the interval from randomization to death from any cause, PFS is the interval from Cycle 1 Day 1 to: • Disease progression (≥ 25% increase in spleen volume) or • Leukemic transformation (bone marrow blasts ≥20% or peripheral blood blasts ≥ 20% associated with an absolute blast count of at least 1 x 109/L that lasts for at least 2 weeks) or • Death from any cause, Leukemia-free survival is defined as the interval from Cycle 1 Day 1 to the date of first documented transformation to leukemia (bone marrow blasts ≥20% or peripheral blood blasts ≥20% associated with an absolute blast count of at least 1 x 109/L that lasts for at least 2 weeks)., Analyses of the safety endpoints will include the following measurements or assessments: physical examinations, laboratory tests, adverse events (AEs), serious AEs (SAEs), electrocardiograms (ECGs), and vital signs, Navtemadlin, acyl glucuronide metabolite (M1) and ruxolitinib PK parameters will be determined, including but not limited to: • Maximum observed concentration (Cmax) • Minimum observed concentration (Cmin) • Area under the plasma concentration-time curve (AUC) • Time of maximum plasma concentration

Source: https://euclinicaltrials.eu/ctis-public/view/2024-514468-26-00